EU clinical trial 2024-512220-11-00: A two-part trial in healthy volunteers to find out how long JNJ-77242113 stays in and acts on the body when administered as different tablet formulations and under different food and water conditions, and to assess the acceptability profile (taste, palatability, and smell) of JNJ-77242113 formulations.
Protocol code: 77242113PSO1008
Sponsor: Janssen Cilag International (Pharmaceutical company). Phase: Human Pharmacology (Phase I)- Other. Countries: Belgium (ended).
Therapeutic area(s): Diseases [C] - Immune System Diseases [C20]
Gender: Female, Male. Age: 18-64 years. Enrolment: 76.
Status: Ended. Start date (EU): 2024-05-23. End date (EU): 2025-06-03. Decision date: 2024-05-03. Results received: No. Last updated: 2025-01-21.

Condition(s): Inflammatory Conditions

Source: https://euclinicaltrials.eu/ctis-public/view/2024-512220-11-00